EU clinical trial 2024-511166-36-00: An Extension Study in Patients with Moderate to Severe Plaque Psoriasis to Evaluate the Long-term Safety, Efficacy and Durability of Response to ESK-001 (ONWARD3)
Protocol code: ESK-001-018
Sponsor: Alumis Inc. (Pharmaceutical company). Phase: Therapeutic confirmatory (Phase III). Countries: Belgium (ended), France (ongoing, recruitment ended), Portugal (ongoing, recruitment ended), Germany (ongoing, recruitment ended), Czechia (ongoing, recruitment ended), Spain (ongoing, recruitment ended), Latvia (ongoing, recruitment ended), Romania (ended), Estonia (ongoing, recruitment ended), Bulgaria (ongoing, recruitment ended), Poland (ongoing, recruitment ended), Hungary (ongoing, recruitment ended), Austria (ended).
Therapeutic area(s): Diseases [C] - Skin and Connective Tissue Diseases [C17]
Gender: Female, Male. Age: 18-64 years, 65+ years. Enrolment: 931.
Start date (EU): 2025-06-13. Decision date: 2025-04-29. Results received: No. Last updated: 2026-07-09.
Decision dates by country: AT: 2025-05-06, BE: 2025-04-29, RO: 2025-05-06, EE: 2025-05-06, PT: 2025-05-02, FR: 2025-04-29, LV: 2025-04-30, ES: 2025-04-30, CZ: 2025-04-30, PL: 2025-05-05, HU: 2025-05-05, DE: 2025-04-30, BG: 2025-05-08

Condition(s): Moderate to Severe Plaque Psoriasis
Product: ESK-001 placebo / Pharmaceutical Form: Film-coated tablet / Route of administration: Oral use / Maximum duration of treatment: 24 weeks, ESK-001

Primary endpoint: Incidence and severity of treatment-emergent adverse events and serious adverse events
Endpoint(s): Long-term efficacy endpoints: * Achievement of ≥75%, ≥90%, and ≥100% reductions in PASI after 24, 48, 72, 96 weeks of overall ESK-001 treatment * Achievement of sPGA-0, sPGA-0/1 and ssPGA after 24, 48, 72, 96 weeks of overall ESK-001 treatment * Mean change from baseline in PASI %BSA, Clinical response endpoints: * Following ESK-001 withdrawal, loss of response in: PASI-75 sPGA-0/1 PASI-90 PASI-100 and median time to loss of response in PASI-75 and sPGA0/1. * After achievement of a response at Week 24 in parent study, maintenance of the response in the following at Weeks 24 and 48 in LTE: PASI-75, PASI-90, and PASI-100 sPGA-0 and sPGA-0/1, Clinical response endpoints (continued): * Lack of response at Week 24 in parent study followed by an achievement of response in the following at Weeks 24 and 48 in LTE: PASI-75, PASI-90, and PASI-100 sPGA-0 and sPGA-0/1, Quality of life endpoints: * Achievement of the following after 24, 48, 72, 96 weeks of overall ESK-001 treatment: DLQI-0/1 Change from baseline in DLQI, PSSD, NRS (Pruritus, Joint Pain, and Joint Disease Activity), SF-36 * After achievement of a response at Week 24 in parent study, maintenance of the response in the following at Weeks 24 and 48 in LTE: DLQI-0/1 4 point improvement in DLQI PSSD-0

Source: https://euclinicaltrials.eu/ctis-public/view/2024-511166-36-00